EU clinical trial 2025-520712-34-00: NON-IV: Neo-adjuvant peritumOral immuNotherapy In Vulvar cancer
Protocol code: 31123
Sponsor: Amsterdam UMC Stichting (Patient organisation/association). Phase: Human Pharmacology (Phase I)- Other. Countries: Netherlands (ongoing, recruiting).
Therapeutic area(s): Diseases [C] - Neoplasms [C04]; Diseases [C] - Female Urogenital Diseases and Pregnancy Complications [C13]
Gender: Female. Age: 18-64 years. Enrolment: 24.
Status: Ongoing, recruiting. Start date (EU): 2026-02-04. Decision date: 2025-08-14. Results received: No. Last updated: 2025-12-16.

Condition(s): Vulvar Cancer

Source: https://euclinicaltrials.eu/ctis-public/view/2025-520712-34-00